EU clinical trial 2024-517074-17-00: Tau and Amyloid PET imaging in normal aging, early Alzheimer's disease and related syndroms.
Protocol code: UCL-2016-121
Sponsor: Cliniques Universitaires Saint-Luc (Hospital/Clinic/Other health care facility). Phase: Phase II and Phase III (Integrated). Countries: Belgium (ongoing, recruiting).
Therapeutic area(s): Analytical, Diagnostic and Therapeutic Techniques and Equipment [E] - Diagnosis [E01]; Diseases [C] - Nervous System Diseases [C10]
Gender: Female, Male. Age: 18-64 years, 65+ years. Enrolment: 500.
Status: Ongoing, recruiting. Start date (EU): 2019-05-20. Decision date: 2024-10-09. Results received: No. Last updated: 2024-10-09.

Condition(s): Alzheimer's disease
Product: F18-MK6240

Primary endpoint: F18-MK6240 regional SUVr or spatial extension measure differences between patients and controls
Endpoint(s): Associations between F18-MK6240 regional SUVr or spatial extension measures and: Cognitive outcomes - Global cognitive measures - Verbal Episodic Memory - Visuospatial/Constructional - Language - Attention/Executive Functioning - Spatial navigational skills; - Face perception and recognition abilities; Specific semantic memory measures; - Short-term memory binding abilities; - Specific episodic memory processes; - Implicit learning abilities., Associations between F18-MK6240 regional SUVr or spatial extension measures and CSF biomarker outcomes - Aβ, t-tau, p-tau, Associations between F18-MK6240 regional SUVr or spatial extension measures and Amyloid-PET imaging - Global and regional distribution of amyloid deposition, Associations between F18-MK6240 regional SUVr or spatial extension measures and Neuroimaging outcomes (MRI) - Regional and whole brain volume - Regional cortical thickness - Resting-state functional connectivity - Diffusion-weighted imaging - Task-related brain activity, Associations between F18-MK6240 regional SUVr or spatial extension measures and Blood-derived biomarkers - Amyloid oligomers - Phosphorylated and non-phosphorylated tau species

Source: https://euclinicaltrials.eu/ctis-public/view/2024-517074-17-00